EU clinical trial 2024-517885-40-00: Randomized clinical study to analyse the effects of dapagliflozin on renal morphology and renal perfusion in patients with impaired renal function one year after kidney transplantation
Protocol code: Dapa-TxV1.0
Sponsor: Universitaetsklinikum Erlangen AöR (Hospital/Clinic/Other health care facility). Phase: Therapeutic use (Phase IV). Countries: Germany (ongoing, recruiting).
Therapeutic area(s): Not possible to specify
Gender: Female, Male. Age: 18-64 years, 65+ years. Enrolment: 48.
Status: Ongoing, recruiting. Start date (EU): 2023-07-03. Decision date: 2024-09-18. Results received: No. Last updated: 2024-09-18.

Condition(s): Chronic Kidney Disease (CKD)
Product: Forxiga 10 mg film-coated tablets

Primary endpoint: Renal morphology (e.g. integrity of peritubular fibroblasts (PDGFRα)), markers of inflammation (CD3, CD68, CD163) and oxidative stress (Nox1, 8-OHdG) in the interstitium assessed from the routine one year follow up biopsy of the renal transplant

Source: https://euclinicaltrials.eu/ctis-public/view/2024-517885-40-00